EU clinical trial 2023-510507-21-00: EvER-ILD 3 : Evaluation of Efficacy and safety of Rituximab and mycophenolate mofetil combination in patients with Interstitial Lung Disease related to systemic sclerosis: a multicentre double-blind placebo-controlled randomized trial.
Protocol code: DR230333
Sponsor: Centre Hospitalier Regional Universitaire De Tours (Hospital/Clinic/Other health care facility). Phase: Phase II and Phase III (Integrated). Countries: France (ongoing, recruiting).
Therapeutic area(s): Diseases [C] - Respiratory Tract Diseases [C08]; Diseases [C] - Immune System Diseases [C20]
Gender: Female, Male. Age: 18-64 years, 65+ years. Enrolment: 102.
Status: Ongoing, recruiting. Start date (EU): 2025-01-08. Decision date: 2024-10-01. Results received: No. Last updated: 2024-10-01.

Condition(s): Intersitial lung disease related to systemic sclerosis
Product: SODIUM CHLORIDE, RITUXIMAB, MYCOPHENOLIC ACID

Primary endpoint: The primary outcome is the change in Forced Vital Capacity (FVC) (in % predicted) from baseline to week 24 with measures at baseline, week 12 and week 24.
Endpoint(s): 1) Change in % of predicted FVC (% FVC) from baseline to week 48, 2) Change in FVC (mL) from baseline to weeks 24 and 48, 3) Change from baseline to weeks 24 and 48 in modified Rodnan skin score (mRSS), 4) Progression free survival (PFS) to weeks 24 and 48, defined as the time to (first event considered): a) a first acute exacerbation, or b) a relative decline in the FVC of ≥ 10% of the predicted value, or c) inclusion on a lung transplant list, or d) inclusion for a therapeutic intensification by autologous haematological stem cell transplantation (AHSCT), or e) death., 5) Overall survival (OS), 6) Changes from baseline to weeks 24 and 48 in the EULAR ScleroID questionnaire, King’s Brief Interstitial Lung Disease (K-BILD) questionnaire and LF-P symptom and impact questionnaire, 7) Cumulative doses of corticosteroids at week 24 and 48, 8) Changes from baseline to weeks 24 and 48 in % of predicted diffusing capacity for carbon monoxide (DLCO), 9) Changes from baseline to weeks 24 and 48 in the 6-minute walk test, 10) Change from baseline to week 24 in accelerometer-assessed physical activity, 11) Changes from baseline to week 48 in high-resolution computed tomography (HRCT) of chest images, 12) Changes from baseline to week 48 of biological markers related to B-cell depletion: CD19 B-cells and gamma globulins, 13) All adverse events, especially serious infectious adverse events, occurring during the 48 weeks treatment period, 14) Pharmacokinetic parameters of rituximab: volume of distribution, rituximab clearance and half-life

Source: https://euclinicaltrials.eu/ctis-public/view/2023-510507-21-00